EU clinical trial 2025-523160-20-00: A Phase 1 Study of IM-1021 in Participants with Advanced Cancer
Protocol code: IM-1021-101
Sponsor: Immunome Inc. (Pharmaceutical company). Phase: Human Pharmacology (Phase I)- First administration to humans. Countries: France (ongoing, recruiting), Spain (ongoing, recruiting), Denmark (ongoing, recruiting), Italy (authorised, recruitment pending).
Therapeutic area(s): Diseases [C] - Neoplasms [C04]
Gender: Female, Male. Age: 18-64 years, 65+ years. Enrolment: 41.
Start date (EU): 2026-03-23. Decision date: 2026-02-16. Results received: No. Last updated: 2026-03-03.
Decision dates by country: DK: 2026-02-16, FR: 2026-02-16, IT: 2026-02-23, ES: 2026-02-18

Condition(s): Advanced solid tumors, Advanced B-cell lymphomas

Source: https://euclinicaltrials.eu/ctis-public/view/2025-523160-20-00